EU clinical trial 2024-511887-10-00: A Phase II Multicenter, Open-Label, Single Arm Study to Determine the Efficacy, Safety and Tolerability of AZD2811 and Durvalumab Combination as Maintenance Therapy After Induction with Platinum-Based Chemotherapy Combined with Durvalumab, for the First-Line Treatment of Patients with Extensive Stage Small-Cell Lung Cancer
Protocol code: D6132C00001
Sponsor: AstraZeneca AB (Pharmaceutical company). Phase: Therapeutic exploratory (Phase II). Countries: Spain (ongoing, recruitment ended).
Therapeutic area(s): Diseases [C] - Neoplasms [C04]
Gender: Female, Male. Age: 18-64 years, 65+ years. Enrolment: 3.
Status: Ongoing, recruitment ended. Start date (EU): 2021-09-14. Decision date: 2024-07-16. Results received: No. Last updated: 2026-02-09.
Decision dates by country: ES: 2024-09-06

Condition(s): First-line patients with extensive disease small-cell lung cancer (SCLC)
Product: Defosbarasertib, IMFINZI 50 mg/mL concentrate for solution for infusion.

Primary endpoint: Maintenance participants alive and progression free (APF12)
Endpoint(s): Maintenance participants alive at 12 months (OS12), 15 months (OS15), and 18 months (OS18), Maintenance participants alive and progression free at 6 months (APF6) and 9 months (APF9) using investigator assessments according to RECIST 1.1, Objective response rate (ORR) for all participants using investigator assessments according to RECIST 1.1, Maintenance participants Progression-free survival (PFS) using investigator assessments according to RECIST 1.1, Overall survival (OS) in maintenance participants, The safety and tolerability profile of study intervention in SCLC, The pharmacokinetics of durvalumab and AZD2811, Disease-related symptoms & Health-related QoL measured by EORTC QLQ-LC30 & EORTC QLQ-LC13

Source: https://euclinicaltrials.eu/ctis-public/view/2024-511887-10-00